EU clinical trial 2024-515676-12-00: DERMOS study : Influence of dermocorticoids on bone mineral density in patients with bullous pemphigoid.
Sponsor: Centre Hospitalier Universitaire Amiens Picardie (Hospital/Clinic/Other health care facility). Phase: Therapeutic use (Phase IV). Countries: France (authorised, recruitment pending).
Therapeutic area(s): Diseases [C] - Skin and Connective Tissue Diseases [C17]
Gender: Female, Male. Age: 18-64 years, 65+ years. Enrolment: 50.
Status: Authorised, recruitment pending. Decision date: 2024-07-31. Results received: No. Last updated: 2024-07-31.

Condition(s): Bullous pemphigoid
Product: CLOBETASOL PROPIONATE

Primary endpoint: Variation in bone mineral density (BMD) expressed in g/cm² at level of the lumbar spine between the initial BMD at M0 and that achieved at the end of theoretical treatment at M6.
Endpoint(s): Correlation between total exposure to topical corticosteroids and reduction in BMO, Variation in BMO between M0 and M3 at the lumbar spine., Variation in BMO between M0 and M3 and M6 at the hip., Varation in plasma concentrations of corrected serum calcium, phosphorus, 25 OH vitamin D and cortisolemia at 8 a.m. between M0, M3 and M6., Frequency of fractures (axial and/or peripheral) according to exposure to corticosteroids at M6., Correlation between these different biological parameters and density bone mineral at M0, M3 and M6.

Source: https://euclinicaltrials.eu/ctis-public/view/2024-515676-12-00